EU clinical trial 2023-509750-58-00: A Phase 3 Study of the Hepcidin Mimetic Rusfertide (PTG-300) in Patients with Polycythemia Vera
Protocol code: VERIFY
Sponsor: Takeda Development Center Americas Inc. (Pharmaceutical company). Phase: Therapeutic confirmatory (Phase III). Countries: Spain (ongoing, recruitment ended), Portugal (ended), Belgium (ongoing, recruitment ended), Netherlands (ongoing, recruitment ended), Germany (ongoing, recruitment ended), Hungary (ongoing, recruitment ended), Poland (ongoing, recruitment ended), Italy (ongoing, recruitment ended), Austria (ongoing, recruitment ended), France (ongoing, recruitment ended), Czechia (ongoing, recruitment ended).
Therapeutic area(s): Diseases [C] - Neoplasms [C04]
Gender: Female, Male. Age: 18-64 years, 65+ years. Enrolment: 102.
Start date (EU): 2022-09-21. Decision date: 2024-04-10. Results received: No. Last updated: 2026-08-07.
Decision dates by country: PT: 2024-04-11, PL: 2024-04-12, NL: 2024-04-10, ES: 2024-04-12, IT: 2024-05-13, HU: 2024-04-12, DE: 2024-04-12, CZ: 2024-04-12, BE: 2024-04-17, AT: 2024-04-15, FR: 2024-05-22

Condition(s): Polycythemia Vera
Product: Rusfertide 10mg, Rusfertide 30mg, Rusfertide 20mg, Placebo to Match PTG-300 for Injection. Formulation (lyophilized powder) is based upon that of PTG-300 for Injection, with the drug substance omitted., Rusfertide 60mg, Rusfertide 45mg

Primary endpoint: Proportion of subjects achieving a response starting at Week 20 through Week 32 (inclusive) who receive rusfertide compared to placebo. A response is defined as absence of phlebotomy eligibility. Phlebotomy eligibility is defined as either: • a confirmed hematocrit ≥45% and that is at least 3% higher than the baseline hematocrit (value immediately prior to randomization at Week 0); or • a hematocrit ≥48%.
Endpoint(s): 1 - Mean number of phlebotomies between Week 0 through Week 32 (inclusive)., 2 - Proportion of subjects with all hematocrit values <45% between Week 0 through Week 32 (inclusive)., 3 - Mean change from baseline at end of Part 1a (Week 32) in the Patient Reported Outcomes Measurement Information System (PROMIS) Fatigue Short Form 8a total T-score, 4 - Mean change from baseline at end of Part 1a (Week 32) in the Myelofibrosis Symptom Assessment Form version 4.0 (MFSAF), 5 - Mean change from baseline at end of Part 1a (Week 32) in the Myeloproliferative Neoplasm Symptom Assessment Form (MPN-SAF)

Source: https://euclinicaltrials.eu/ctis-public/view/2023-509750-58-00